EU clinical trial 2024-514815-92-00: A Phase 3, Multicenter, Open-Label Extension Trial of Oral RPC1063 as Therapy for Moderate to Severe Ulcerative Colitis
Protocol code: RPC01-3102
Sponsor: Celgene International II SARL (Pharmaceutical company). Phase: Therapeutic confirmatory (Phase III). Countries: Belgium (ended), Romania (ended), Poland (ended), Czechia (ended), Hungary (ended), Italy (ended), Bulgaria (ended).
Therapeutic area(s): Diseases [C] - Digestive System Diseases [C06]
Gender: Female, Male. Age: 18-64 years, 65+ years. Enrolment: 223.
Status: Ended. Start date (EU): 2015-07-16. End date (EU): 2024-12-18. End date: 2024-12-20. Decision date: 2024-08-22. Results received: Yes. Last updated: 2025-01-29.
Decision dates by country: BE: 2024-08-22, CZ: 2024-08-23, HU: 2024-08-26, RO: 2024-08-27, PL: 2024-08-30, IT: 2024-09-04, BG: 2024-09-13

Condition(s): Ulcerative colitis
Product: Ozanimod, Ozanimod

Primary endpoint: Efficacy Endpoints: • Proportion of patients in clinical remission. • Proportion of patients with a clinical response • Proportion of patients with endoscopic improvement • Proportion of patients with mucosal healing • Proportion of patients with corticosteroid-free remission • Change from Baseline in complete Mayo score, partial Mayo score, and 9-point Mayo score • Proportion of patients with histologic remission • Proportion of patients with clinical response, clinical remission, or endoscopic, Safety Endpoints: - The incidence, severity, and relationship of treatment-emergent adverse events (TEAEs), serious AEs (SAEs), TEAEs leading to discontinuation of investigational drug, AEs of special interest (AESIs), and TEAEs of special interest will be summarized. - Exploratory safety endpoints include changes from baseline for clinical laboratory measures, vital signs, ECGs, and pulmonary function tests.

Source: https://euclinicaltrials.eu/ctis-public/view/2024-514815-92-00